EU clinical trial 2024-518417-25-00: Feasibility clinical trial of the combination of AloCelyvir with chemotherapy and radiotherapy for the treatment of children and adolescents with relapsed or refractory extracranial solid tumors.
Protocol code: FIBHNJ-2019-01
Sponsor: Fundacion Para La Investigacion Biomedica Hospital Infantil Universitario Nino Jesus (Hospital/Clinic/Other health care facility). Phase: Human Pharmacology (Phase I)- Other. Countries: Spain (authorised, recruitment pending).
Therapeutic area(s): Diseases [C] - Neoplasms [C04]
Gender: Female, Male. Age: 0-17 years, 18-64 years. Enrolment: 24.
Status: Authorised, recruitment pending. Decision date: 2024-10-10. Results received: No. Last updated: 2024-10-10.

Condition(s): Relapsed or refractory extracranial solid tumors in children and adolescents.
Product: AloCelyvir

Primary endpoint: Dose confirmation phase: Rate of dose-limiting toxicities.
Endpoint(s): Expansion phase: Rate of objective responses (complete and partial responses) of the combination., Feasibility of the combination: rate of patients who meet selection criteria who can receive at least one cycle of the combination of Alo-Celyvir with chemo-radiotherapy and measurement of the time from recruitment to the preparation and administration of Alo-Celyvir., Dose confirmation phase: Rate of objective responses (complete and partial responses) of the combination., Progression free survival., Global survival., Rate of adverse events.

Source: https://euclinicaltrials.eu/ctis-public/view/2024-518417-25-00